EU clinical trial 2024-516004-42-01: A Phase 2 Clinical Trial of Nivolumab, or Nivolumab Combinations, in Recurrent and Metastatic Microsatellite Instability High (MSI-H) and non-MSI-H Colon Cancer
Protocol code: CA209-142
Sponsor: Bristol Myers Squibb International Corporation (Pharmaceutical company). Phase: Therapeutic exploratory (Phase II). Countries: Belgium (ended), Italy (ended).
Therapeutic area(s): Diseases [C] - Neoplasms [C04]
Gender: Female, Male. Age: 18-64 years, 65+ years. Enrolment: 143.
Status: Ended. Start date (EU): 2014-05-14. End date (EU): 2024-10-01. End date: 2024-10-23. Decision date: 2024-10-01. Results received: Yes. Last updated: 2024-10-14.
Decision dates by country: BE: 2024-10-01, IT: 2024-10-14

Condition(s): MSI Negative Colorectal Cancer, MSI Positive Colorectal Cancer
Product: OPDIVO 10 mg/mL concentrate for solution for infusion., Ipilimumab, OPDIVO 10 mg/mL concentrate for solution for infusion., DARZALEX 20 mg/mL concentrate for solution for infusion, Relatlimab, Relatlimab

Primary endpoint: Objective response rate (ORR) in all MSI-High and non-MSI-High subjects as determined by Investigators
Endpoint(s): ORR in all MSI-H and non-MSI-H subjects based on IRRC

Source: https://euclinicaltrials.eu/ctis-public/view/2024-516004-42-01